EU clinical trial 2022-501784-40-00: A Phase 3, Open-label, Randomized Study of Nivolumab Combined with Ipilimumab, or with Standard of Care Chemotherapy, versus Standard of Care Chemotherapy in Participants with Previously Untreated Unresectable or Metastatic Urothelial Cancer
Protocol code: CA209-901
Sponsor: Bristol-Myers Squibb Services Unlimited Company (Pharmaceutical company). Phase: Therapeutic confirmatory (Phase III). Countries: Germany (ended), Greece (ended), Denmark (ended), France (ended), Romania (ended), Poland (ended), Norway (ended), Czechia (ended), Netherlands (ended), Spain (ended), Italy (ended).
Therapeutic area(s): Diseases [C] - Neoplasms [C04]
Gender: Female, Male. Age: 18-64 years, 65+ years. Enrolment: 701.
Status: Ended. Start date (EU): 2017-05-26. End date (EU): 2025-07-09. Decision date: 2024-03-08. Results received: No. Last updated: 2026-05-29.
Decision dates by country: DE: 2024-03-13, RO: 2024-03-21, NO: 2024-03-08, DK: 2024-03-11, PL: 2024-03-20, GR: 2024-04-22, NL: 2024-03-11, CZ: 2024-03-11, ES: 2024-03-11, FR: 2024-03-12, IT: 2024-03-21

Condition(s): Untreated Unresectable or Metastatic Urothelial Cancer
Product: CISPLATIN-EBEWE, 1 MG/ML, KONCENTRAT DO SPORZĄDZANIA ROZTWORU DO INFUZJI, CARBO-cell® 10 mg/ml Infusionslösung, Konzentrat zur Herstellung einer Infusionslösung, Gemcitabine 1 g Powder for Solution for Infusion, Gemcitabine 38 mg/ml Concentrate for Solution for Infusion, OPDIVO 10 mg/mL concentrate for solution for infusion., Cisplatin Teva® 1 mg/ml Konzentrat zur Herstellung einer Infusionslösung, Carboplatin Bendalis 10 mg/ml Konzentrat zur Herstellung einer Infusionslösung, Carbomedac® 10 mg/ml Konzentrat zur Herstellung einer Infusionslösung, GEMCI-cell® 38 mg/ml Konzentrat zur Herstellung einer Infusionslösung, YERVOY 5 mg/ml concentrate for solution for infusion, Cisplatin NeoCorp 1 mg/ml - Konzentrat zur Herstellung einer Infusionslösung

Primary endpoint: Primary endpoint of OS in cisplatin-ineligible randomized participants, Primary endpoint of OS in PD-L1 positive (>= 1%) randomized participants by immunohistochemistry (IHC)
Endpoint(s): OS in all randomized participants, PFS by blinded independent central review (BICR) (using RECIST 1.1) in cisplatin-ineligible randomized participants, in PD-L1 positive (>=1%) randomized participants and in all randomized participants, European Organisation for Research and Treatment of Care (EORTC) QLQ-C30 Global Health Status score in all randomized participants

Source: https://euclinicaltrials.eu/ctis-public/view/2022-501784-40-00